EU clinical trial 2024-513127-16-00: A randomized, placebo-controlled, double blind, multiple ascending dose, phase 1 study to evaluate the safety, tolerability, and pharmacokinetics of QRL-101 in healthy participants
Protocol code: QRL-101-03
Sponsor: Quralis Corp. (Pharmaceutical company). Phase: Human Pharmacology (Phase I)- Other. Countries: Netherlands (ended).
Therapeutic area(s): Diseases [C] - Nervous System Diseases [C10]
Gender: Female, Male. Age: 18-64 years, 65+ years. Enrolment: 60.
Status: Ended. Start date (EU): 2024-06-24. End date (EU): 2025-01-14. Decision date: 2024-06-20. Results received: No. Last updated: 2025-01-13.

Condition(s): NA - healthy volunteers

Source: https://euclinicaltrials.eu/ctis-public/view/2024-513127-16-00